EU clinical trial 2022-502381-25-01: A phase I, open-label, multi-center study of KFA115 as a single agent and in combination with pembrolizumab in patients with select advanced cancers
Protocol code: CKFA115A12101
Sponsor: Novartis Pharma AG (Pharmaceutical company). Phase: Human Pharmacology (Phase I)- First administration to humans. Countries: Italy (ongoing, recruitment ended), Spain (ongoing, recruitment ended), France (ended), Germany (ongoing, recruitment ended).
Therapeutic area(s): Diseases [C] - Neoplasms [C04]
Gender: Female, Male. Age: 18-64 years, 65+ years. Enrolment: 97.
Start date (EU): 2024-03-15. Decision date: 2024-01-25. Results received: No. Last updated: 2026-08-03.
Decision dates by country: DE: 2024-01-25, ES: 2024-01-26, IT: 2024-01-28, FR: 2024-01-29

Condition(s): Microsatellite Instability High Colorectal Cancer, Non-small cell lung cancer, Clear Cell Renal Cell Carcinoma, Head and Neck Squamous Cell Carcinoma, Cutaneous melanoma, Nasopharyngeal Cancer, Epithelial Ovarian Cancer, Anal Cancer, Esophagogastric Cancer, Thymic Carcinoma, Triple negative breast cancer, Mesothelioma

Source: https://euclinicaltrials.eu/ctis-public/view/2022-502381-25-01